EU clinical trial 2024-513436-14-00: Evaluation of oxytocin treatment in children with autism and intellectual disability’, Multiple-dose Oxytocine - ASD and Intellectual Disability
Sponsor: UZ Leuven (Hospital/Clinic/Other health care facility). Phase: Phase III and phase IV (Integrated). Countries: Belgium (ongoing, recruiting).
Therapeutic area(s): Psychiatry and Psychology [F] - Behavior and Behavior Mechanisms [F01]
Gender: Female, Male. Age: 0-17 years. Enrolment: 80.
Status: Ongoing, recruiting. Start date (EU): 2023-05-30. Decision date: 2024-09-20. Results received: No. Last updated: 2025-04-04.

Condition(s): Autism spectrum disorder (ASD)
Product: sodium chloride nose drops 0.9%, Oxytocine CD Pharma 40 IE/ml neusspray, oplossing, Syntocinon 40 IE/ml neusspray, oplossing

Primary endpoint: The Brief Observation of Social Communication Change (BOSCC) (clinician-rated), The Autism Treatment Evaluation Checklist (ATEC) (parent (caregiver) and teacher-rated), Recordings of electrocardiography (ECG) for the assessment of heart rate variability (HRV) during rest
Endpoint(s): The Repetitive Behavior Scale - Revised (RBS-R) (parent (caregiver) and teacher-rated), The Adaptive Behavior Assessment System (ABAS-3) (parent (caregiver)-rated), The Developmental Behaviour Checklist (DBC) (parent (caregiver)-rated), The Perceived Stress Scale (PSS) (parent (caregiver)-rated), The Child’s Sleep Habits Questionnaire Abbreviated (CSHQ-A) (parent (caregiver)-rated)

Source: https://euclinicaltrials.eu/ctis-public/view/2024-513436-14-00